EU clinical trial 2025-522971-27-00: Open-label, randomized, two-period, two-treatment, two-sequence, crossover, balanced, study to assess the bioequivalence between the test product Betahistine dihydrochloride 24 mg tablets from Esperante Development BV and reference product Betaserc® 24 mg tablets.
Protocol code: ESP 301/BE
Sponsor: Esperante Development B.V. (Pharmaceutical company). Phase: Human Pharmacology (Phase I)- Bioequivalence Study. Countries: Czechia (ended).
Therapeutic area(s): Diseases [C] - Otorhinolaryngologic Diseases [C09]
Gender: Female, Male. Age: 18-64 years. Enrolment: 24.
Status: Ended. Start date (EU): 2025-10-20. End date (EU): 2025-11-19. Decision date: 2025-10-08. Results received: No. Last updated: 2025-10-08.

Condition(s): Bioequivalence study under fasting conditions

Source: https://euclinicaltrials.eu/ctis-public/view/2025-522971-27-00